EU clinical trial 2024-510900-34-00: A Phase 1 Open-label Study to Assess the Safety, Tolerability, Pharmacokinetics, and Pharmacodynamics of PAS-004, a MEK (1/2) Inhibitor, in Patients with MAPK Pathway-driven Advanced Solid Tumors with a Documented RAS, NF1, or RAF Mutation or Patients who have Failed BRAF/MEK Inhibition
Sponsor: Pasithea Therapeutics Corp. (Hospital/Clinic/Other health care facility). Phase: Human Pharmacology (Phase I)- First administration to humans. Countries: Bulgaria (ongoing, recruiting), Romania (ongoing, recruiting).
Therapeutic area(s): Not possible to specify
Gender: Female, Male. Age: 18-64 years, 65+ years. Enrolment: 24.
Status: Ongoing, recruiting. Start date (EU): 2024-11-22. Decision date: 2024-06-24. Results received: No. Last updated: 2026-08-07.
Decision dates by country: RO: 2024-06-25, BG: 2024-06-24

Condition(s): Solid Tumors

Source: https://euclinicaltrials.eu/ctis-public/view/2024-510900-34-00